EU clinical trial 2025-520541-72-00: NBI-1065845-MDD3027: A Randomized, Double-Blind, Placebo-Controlled Study to Evaluate the Maintenance of Effect of NBI 1065845 as an Adjunctive Treatment in Subjects with Major Depressive Disorder (MDD)
Protocol code: NBI-1065845-MDD3027
Sponsor: Neurocrine Biosciences Inc. (Pharmaceutical company). Phase: Therapeutic confirmatory (Phase III). Countries: Bulgaria (ongoing, recruiting), Estonia (ongoing, recruiting), Poland (ongoing, recruiting), Italy (ongoing, recruiting), Spain (ongoing, recruiting).
Therapeutic area(s): Psychiatry and Psychology [F] - Mental Disorders [F03]
Gender: Female, Male. Age: 18-64 years, 65+ years. Enrolment: 158.
Status: Ongoing, recruiting. Start date (EU): 2025-10-22. Decision date: 2025-09-16. Results received: No. Last updated: 2026-05-08.
Decision dates by country: PL: 2025-09-19, BG: 2025-09-18, ES: 2025-10-07, EE: 2025-09-16, IT: 2025-09-25

Condition(s): Major Depressive Disorder
Product: NBI-1065845, Identical to NBI-1065845 tablets without active drug

Primary endpoint: The primary endpoint for this study will be the time from randomization to relapse.

Source: https://euclinicaltrials.eu/ctis-public/view/2025-520541-72-00